EU clinical trial 2025-522244-40-00: Study in healthy volunteers to compare the blood levels after epoetin alfa (Blau EPO) and Erypo, administered as a single intravenous injection as well as safety, tolerability and the effects on certain blood values.
Protocol code: EPOBLAIV25011
Sponsor: Blau Farmaceutica S.A. (Pharmaceutical company). Phase: Human Pharmacology (Phase I)- Other. Countries: Germany (authorised, recruitment pending).
Therapeutic area(s): Diseases [C] - Hemic and Lymphatic Diseases [C15]
Gender: Female, Male. Age: 18-64 years. Enrolment: 64.
Status: Authorised, recruitment pending. Decision date: 2026-03-13. Results received: No. Last updated: 2026-03-13.

Condition(s): It is used to treat symptomatic anaemia in chronic renal failure

Source: https://euclinicaltrials.eu/ctis-public/view/2025-522244-40-00